EU clinical trial 2024-515889-14-00: Bioequivalence study of GP-IMP-001 with regards to reference product
Protocol code: Gebro-I-56.1
Sponsor: Gebro Pharma GmbH (Pharmaceutical company). Phase: Human Pharmacology (Phase I)- Bioequivalence Study. Countries: Czechia (ended).
Therapeutic area(s): Not possible to specify
Gender: Male. Age: 18-64 years. Enrolment: 24.
Status: Ended. Start date (EU): 2025-01-22. End date (EU): 2025-02-26. Decision date: 2024-12-19. Results received: No. Last updated: 2025-01-10.

Condition(s): healthy volunteers

Source: https://euclinicaltrials.eu/ctis-public/view/2024-515889-14-00